EU clinical trial 2024-511894-32-00: The assessment of cysteinyl leukotriene receptor antagonist role in inhibition of atherosclerosis, proliferation and its influence on endothelial function in patients undergoing endovascular treatment due to peripheral arterial disease.
Protocol code: CADET-PAD
Sponsor: Uniwersytet Jagiellonski Collegium Medicum (Educational Institution). Phase: Therapeutic confirmatory (Phase III). Countries: Poland (ended).
Therapeutic area(s): Diseases [C] - Cardiovascular Diseases [C14]
Gender: Female, Male. Age: 18-64 years, 65+ years. Enrolment: 200.
Status: Ended. Start date (EU): 2021-08-19. End date (EU): 2026-05-12. Decision date: 2024-07-01. Results received: No. Last updated: 2024-07-01.

Condition(s): Ischemia of the lower limbs in the course of obstructive artery disease
Product: lactose monohydrate - 100,00 mg/tablet cellulose microcrystalline - 95,60 mg/tablet; Croscarmellose sodium - 2,00 mg/tablet; Magnesium stearate - 2,40 mg/tablet table coating - OPADRY 20A82938 Yellow - COLORCON, Asmenol, 10 mg, tabletki powlekane

Primary endpoint: Restenosis in a previously treated artery
Endpoint(s): MACE, high lower limb amputation, significant loss in quality of life

Source: https://euclinicaltrials.eu/ctis-public/view/2024-511894-32-00